EU clinical trial 2024-511880-27-00: Multisite open-label randomized phase II clinical trial in newly diagnosed glioblastoma treated by concurrent TemoRadiation and adjuvant temozolomide +/- ultrasound-induced blood brain barrier opening - SonoFIRST
Protocol code: APHP200080
Sponsor: Assistance Publique Hopitaux De Paris (Hospital/Clinic/Other health care facility). Phase: Therapeutic exploratory (Phase II). Countries: France (authorised, recruitment pending), Belgium (authorised, recruitment pending).
Therapeutic area(s): Analytical,Diagnostic,Therapeutic Techniques and Equipment [E]-Surgical Procedures, Operative [E04]; Diseases [C] - Nervous System Diseases [C10]
Gender: Female, Male. Age: 18-64 years, 65+ years. Enrolment: 63.
Status: Authorised, recruitment pending. Decision date: 2024-12-04. Results received: No. Last updated: 2024-12-05.
Decision dates by country: BE: 2024-12-05, FR: 2024-12-04

Condition(s): Newly diagnosed Glioblastoma (IDH wild-type) patients at initial radiological diagnosis eligible for tumor resection, and for the standard of care including concurrent temoradiation followed by adjuvant TMZ with or without Tumor Treating Fields*. (*Tumor Treating Fields is applicable only in participating centers in France)
Product: Luminity 150 microlitres/ml gas and solvent for dispersion for injection/infusion, TEMOZOLOMIDE, LOMUSTINE

Primary endpoint: PFS is defined as the time between randomization and disease progression which is the first documented tumor progression (per local Investigator assessment according to the RANO criteria) or death due to any cause.
Endpoint(s): crPFS: central review Progression Free Survival according to RANO criteria assessed by central independent review, iPFS: immune Progression Free Survival according to iRANO criteria assessed by local investigator, OS: Overall Survival, KPS: Karnofsky Performance Status assessed at all visits until progression., MMSE: Mini Mental Status Examination mean score assessed at randomization, pre-TemoRadiation visit, C1 (baseline after surgery/radiotherapy), C3, C6, M11 and M18 until progression., QLQ-C30: the C30 Quality of Life Questionnaire (QLQ) will be assessed at using the European Organization for Research and Treatment of Cancer, at randomization, pre-TemoRadiation visit, C1 (baseline after surgery/radiotherapy), C3, C6, M11 and M18 until progression., QLQ-BN20PROM: the BN20 Quality of Life Questionnaire (QLQ) will be assessed at using the European Organization for Research and Treatment of Cancer, at randomization, pre-TemoRadiation visit, C1 (baseline after surgery/radiotherapy), C3, C6, M11 and M18 until progression., PainPROM: pain score from surgical area at randomization, pre-TemoRadiation visit, C1 (baseline after surgery/radiotherapy), C3, C6, M11 and M18 until progression. This will be assessed using visual analogic scale., EstheticalPROM: score in self-confidence concerning esthetical dimension of surgical scar at randomization, pre-TemoRadiation visit, C1 (baseline after surgery/radiotherapy), C3, C6, M11 and M18 until progression using esthetical comfort question equivalent to q39 of QLQ-BR23 questionnaire., Safety confirmation is assessed by the frequency and severity of AE (incidence of AE summarized by system organ class and/or preferred term and severity) based on the Common Terminology Criteria for Adverse Events, version 5.0.

Source: https://euclinicaltrials.eu/ctis-public/view/2024-511880-27-00